EU clinical trial 2024-513719-28-00: RECURrence of Atrial Fibrillation after cardioversion of patients randomized to open-label treatment with dapagliflozin or usual care (RECUR-AF)
Sponsor: Karolinska University Hospital (Hospital/Clinic/Other health care facility). Phase: Phase III and phase IV (Integrated). Countries: Sweden (ongoing, recruiting).
Therapeutic area(s): Diseases [C] - Cardiovascular Diseases [C14]
Gender: Female, Male. Age: 18-64 years, 65+ years. Enrolment: 1600.
Status: Ongoing, recruiting. Start date (EU): 2025-06-04. Decision date: 2024-08-14. Results received: No. Last updated: 2024-08-14.

Condition(s): Atrial fibrillation
Product: DAPAGLIFLOZIN

Primary endpoint: Time to recurrence of AF within 30 days after cardioversion.
Endpoint(s): Proportion of patients in sinus rhythm (SR) 30 days after cardioversion., Proportion of patients without any AF recurrence at 30 days, Time to spontaneous return to SR before electrical cardioversion., Spontaneous return to SR before cardioversion., Success of cardioversion (discharged with SR)., Total number of days with AF recordings during 30 days following cardioversion., Absence of clinical AF recurrence (12- lead ECG-verified) during follow-up after EC or after spontaneous return to SR (before EC).

Source: https://euclinicaltrials.eu/ctis-public/view/2024-513719-28-00